EU clinical trial 2025-522331-34-00: A Study to Learn if Multiple Doses of the Study Medicine Called Carbamazepine Changes How the Body Processes the Other Study Medicine PF-07248144
Protocol code: C4551007
Sponsor: Pfizer Inc. (Pharmaceutical company). Phase: Human Pharmacology (Phase I)- Other. Countries: Belgium (ended).
Therapeutic area(s): Diseases [C] - Neoplasms [C04]
Gender: Female, Male. Age: 18-64 years. Enrolment: 12.
Status: Ended. Start date (EU): 2025-09-15. End date (EU): 2026-01-15. End date: 2026-01-16. Decision date: 2025-09-09. Results received: No. Last updated: 2025-09-09.

Condition(s): locally advanced or metastatic ER+/HER2- breast cancer

Source: https://euclinicaltrials.eu/ctis-public/view/2025-522331-34-00